EU clinical trial 2023-505350-18-00: A Randomized, Double-Blind, Placebo-Controlled, Trial to Investigate the Antiviral Effect, Safety, Tolerability and Pharmacokinetics of Orally Administered Capsid Inhibitors in HIV-1 Infected Treatment-Naïve Adults
Protocol code: 218307
Sponsor: Viiv Healthcare UK Limited (Pharmaceutical company). Phase: Therapeutic exploratory (Phase II). Countries: Germany (ended), Italy (ended), Spain (ended), France (ended).
Therapeutic area(s): Diseases [C] - Virus Diseases [C02]
Gender: Female, Male. Age: 18-64 years, 65+ years. Enrolment: 17.
Status: Ended. Start date (EU): 2023-12-15. End date (EU): 2024-02-07. End date: 2024-06-24. Decision date: 2023-12-01. Results received: Yes. Last updated: 2024-06-20.
Decision dates by country: FR: 2023-12-01, DE: 2023-12-05, IT: 2023-12-05, ES: 2023-12-01

Condition(s): HIV Infections
Product: Tablets are oval, biconvex, plain and white to off white, Placebo for GSK4011499 Tablets are tablets for oral administration. Tablets are oval, biconvex, plain, and white to off white.

Primary endpoint: Maximum change from baseline (Day 1) in plasma HIV-1 ribonucleic acid through Day 11.
Endpoint(s): • Incidence of adverse events (AEs), severity of AEs and AEs leading to study treatment discontinuation • Change from baseline and maximum toxicity grade increase from baseline for liver panel laboratory parameters, PK measures that include but are not limited to: • Maximum observed plasma drug concentration (Cmax), • Time to maximum observed plasma drug concentration (tmax), • Concentrations on Day 11 for VH4004280 and VH4011499, VH4004280 and VH4011499 PK parameters with maximum change in plasma HIV-1 RNA from baseline through Day 11

Source: https://euclinicaltrials.eu/ctis-public/view/2023-505350-18-00